EU clinical trial 2024-511502-24-02: OPtimizing Aldosterone Receptor Antagonist Therapy by Sodium Zirconium Cyclosilicate in Heart Failure (OPRA-HF)
Protocol code: ESR-19-20262
Sponsor: Vaestra Goetalandsregionen (Hospital/Clinic/Other health care facility). Phase: Therapeutic exploratory (Phase II). Countries: Sweden (ended).
Therapeutic area(s): Diseases [C] - Cardiovascular Diseases [C14]
Gender: Female, Male. Age: 18-64 years, 65+ years. Enrolment: 1.
Status: Ended. Start date (EU): 2021-08-18. End date (EU): 2026-01-20. Decision date: 2024-08-14. Results received: No. Last updated: 2024-08-14.

Condition(s): High-risk hyperkalemia, Heart failure, Suboptimal heart failure treatment
Product: SODIUM ZIRCONIUM CYCLOSILICATE, RELEASE OF UNLABELLED BULK IMP FOR ESR; Product (strength/dosage form): Placebo for Sodium Zirconium Cyclosilicate powder for oral suspension; Pack size/type: Bulk unlabelled Amcor sachet to match 5 g Manufacturing lot/batch number (AstraZeneca/External): P5D21A04B | L018661; Site of manufacturing (name and site): Sharp Packaging Solutions, Allentown, US; Date of bulk manufacture: 01-Nov-2021; Shelf life: 60 months; Storage conditions: Store below 30°C; Sponsor name: Sahlgrenska University Hospital Östra Hospital Sponsor study reference: ESR-19-20262, (D9484C00005), (OPRA-HF) EUDRACT number 2020-005176-3

Primary endpoint: To demonstrate the efficacy of Sodium Zirconium Cyclosilicate (SZC) on optimizing MRA in HFrEF, SZC vs Placebo. The efficacy will be assessed by difference in the proportion of patients who may or may not maintain MRA at a dose ≥ 25 mg daily or a dose increase by 25 mg daily and K level in the normal range (3.5-5.0 mmol/L) at the end of study, without rescue therapy due to hy-perkalemia at any point during the randomization phase.
Endpoint(s): To determine the efficacy of SZC when compared to placebo in maintaining achieved MRA-dose after run-in period, SZC vs Placebo., To determine the impact of MRA-optimization by SZC in QoL-parameters, SZC vs Place-bo., To determine the estimated treatment persistency of highest tolerable dose (25-50 mg dai-ly) of MRA between SZC vs Placebo., To evaluate the safety and tolerability of SZC when compared to placebo as assessed by differences in percent (%) between the two groups in pre-specified safety endpoints (oc-curring at any point during the study)

Source: https://euclinicaltrials.eu/ctis-public/view/2024-511502-24-02